EU clinical trial 2024-517253-27-00: Collaborative treatment protocol for children and adolescents with acute lymphoblastic leukemia. A randomized phase III study conducted in agreement with the AIEOP-BFM study group.
Protocol code: AIEOP-BFM 2017POLAND
Sponsor: Medical University Of Silesia Katowice Poland (Educational Institution). Phase: Therapeutic confirmatory (Phase III). Countries: Poland (ongoing, recruitment ended).
Therapeutic area(s): Diseases [C] - Neoplasms [C04]
Gender: Female, Male. Age: 0-17 years. Enrolment: 874.
Status: Ongoing, recruitment ended. Start date (EU): 2021-07-01. Decision date: 2024-10-28. Results received: No. Last updated: 2024-10-28.

Condition(s): Acute lymphoblastic leukemia
Product: BLINATUMOMAB, BORTEZOMIB, PREDNISONE, IFOSFAMIDE, CRISANTASPASE, ETOPOSIDE, PREDNISOLONE, DEXAMETHASONE, CYCLOPHOSPHAMIDE, PREDNISOLONE SODIUM SUCCINATE, IFOSFAMIDE, PREDNISOLONE SODIUM SUCCINATE, METHOTREXATE, VINCRISTINE SULFATE, PREDNISONE, PREDNISONE, METHOTREXATE, ETOPOSIDE, DOXORUBICIN HYDROCHLORIDE, METHOTREXATE DISODIUM, DEXAMETHASONE, DEXAMETHASONE PHOSPHATE, METHOTREXATE, ETOPOSIDE, DOXORUBICIN HYDROCHLORIDE, CYTARABINE, PEGASPARGASE, CYTARABINE, PREDNISONE, VINDESINE SULFATE, MERCAPTOPURINE, CYTARABINE, METHOTREXATE, DAUNORUBICIN HYDROCHLORIDE, DOXORUBICIN HYDROCHLORIDE, TIOGUANINE, PREDNISOLONE SODIUM SUCCINATE, ETOPOSIDE, CYTARABINE, PREDNISOLONE SODIUM SUCCINATE, DOXORUBICIN HYDROCHLORIDE, FLUDARABINE PHOSPHATE

Primary endpoint: R-eHR: The primary endpoint will be the time from randomization until the first event defined as follows: • Cytomorphological or molecular non-response (resistance to protocol treatment, considered as event after post-consolidation treatment – HR blocks or blinatumomab therapy), • relapse, • second malignancy or death from any cause. This will be called EFS time., (2a) R-HR: Frequency and incidence of grade 4 adverse events or death from any cause, non-serious adverse events of medical interest during post-consolidation treatment (blinatumomab and HR blocks), (2a) R-HR: Frequency of MRD-negative patients after first and third cycle of Blinatumomab or after the HR-1’/HR-3’ block compared under non-inferiority assumption
Endpoint(s): (1b) Time from randomization to death from any cause, (1c) Frequency and incidence of grade 4 adverse events or death during Consol Bext and after but before 1st day of HR-1` block or 1st blinatumomab cycle., (1c, 2a) Frequency and incidence of AE of special interest and SAE in specific protocol phases, randomized arms and overall during follow-up, (1d) Proportion of children with negative MRD at TP1a and TP2, (2b) Absolute difference in MRD load between TP2 and TP after first blinatumomab cycle or HR-1, (2b) Absolute difference in MRD load between TP2 and third Blinatumomab cycle or HR-3`, (2c) Absolute MRD loads at TP2 and TP HR Blina 1, d29 71, 113 and TP2, TP HR1, TP HR2, TP HR3., (2d) Time from the first day of first Blinatumomab cycle or HR-1` block to event: death from any cause (for OS), death, relapse, secondary malignancy or molecular non-response for EFS)., (1e, 2f) R-eHR, R-HR: appropriately-defined times to events, frequencies of grade 4 adverse events or death and proportion of patients achieving negative MRD at corresponding timepoints.

Source: https://euclinicaltrials.eu/ctis-public/view/2024-517253-27-00